EU clinical trial 2025-520539-17-00: FELICITA - A proof of concept study: open label phase IIa trial evaluating the effect and safety of transplantation of fecal microbiota in children with autism spectrum disorders and gastrointestinal symptoms
Protocol code: APHP241418
Sponsor: Assistance Publique Hopitaux De Paris (Hospital/Clinic/Other health care facility). Phase: Therapeutic exploratory (Phase II). Countries: France (authorised, recruitment pending).
Therapeutic area(s): Phenomena and Processes [G] - Digestive System and Oral Physiological Phenomena [G10]; Psychiatry and Psychology [F] - Mental Disorders [F03]
Gender: Female, Male. Age: 0-17 years. Enrolment: 5.
Status: Authorised, recruitment pending. Decision date: 2025-05-07. Results received: No. Last updated: 2025-05-07.

Condition(s): Austistic spectrum disorder
Product: Enema transplant of fecal microbiota 25g/100mL

Primary endpoint: Rate of children with a success, determined by the reduction of more than 50% of the composite score in the Gastrointestinal Symptoms Rating Scale (GSRS) evaluated by parents between inclusion and week 18. GSRS is validated in French and evaluates the intensity of 5 gastrointestinal symptoms (diarrhea, abdominal pain, constipation, indigestion, and reflux).
Endpoint(s): Improvement on autistic core symptoms and global improvement [at W0, W4, W18, W24, M12] by multiples questionnaires and scales, FMT side effects (antibiotic therapy, GM transplantation from a healthy donor): Pediatric Adverse Event Rating Scale [evaluated by the pediatrician at day (D) 0, D5, W4, W18, W24, M12], Adherence to instruction to be followed during the FMT process, drop out numbers, reasons of drop out, acceptability questionnaire - Stool consistency: Bristol Stool Form Scale [by parents from W0 to W4 and from W17 to W18] and global improvement: Caregiver Strain index [by a psychologist at W0, W4, W18, W24, M12], Pediatric Quality of Life Inventory (PedsQL) [at W0, W18, M12]

Source: https://euclinicaltrials.eu/ctis-public/view/2025-520539-17-00